EU clinical trial 2024-518046-25-00: INtra-operative evaluation of a novel FLUorescENt C-mEt tracer in penile and tongue cancer - INFLUENCE
Sponsor: Het Nederlands Kanker Instituut-Antoni van Leeuwenhoek Ziekenhuis Stichting (Hospital/Clinic/Other health care facility). Phase: Therapeutic exploratory (Phase II). Countries: Netherlands (temporarily halted).
Therapeutic area(s): Diseases [C] - Neoplasms [C04]
Gender: Female, Male. Age: 18-64 years, 65+ years. Enrolment: 20.
Status: Temporarily halted. Start date (EU): 2019-12-17. Decision date: 2024-11-12. Results received: No. Last updated: 2024-11-12.

Condition(s): penile carcinoma, tongue carcinoma
Product: EMI-137

Primary endpoint: The feasibility of intraoperative tumour visualization by means of c-MET targeted fluores-cence imaging will be evaluated, and the imaging result will be correlated to the level of c-MET expression determined using standard immunohistochemistry.
Endpoint(s): Detection and visualization of lymph node metastases in penile and tongue tumour patients., Identification of dysplasia or carcinoma in situ in penile and tongue tumours.

Source: https://euclinicaltrials.eu/ctis-public/view/2024-518046-25-00